EU clinical trial 2023-504924-24-00: C5241014- A Randomized, Phase 1, Single-Blind, Multi-Period Study to Investigate the Palatability of PF-07923568 Oral Suspension in Different Liquid Vehicles in Healthy Adult Participants
Protocol code: C5241014
Sponsor: Pfizer Inc. (Pharmaceutical company). Phase: Human Pharmacology (Phase I)- Other. Countries: Belgium (ended).
Therapeutic area(s): Diseases [C] - Virus Diseases [C02]
Gender: Female, Male. Age: 18-64 years, 65+ years. Enrolment: 12.
Status: Ended. Start date (EU): 2023-07-25. End date (EU): 2023-09-20. End date: 2023-09-21. Decision date: 2023-07-17. Results received: Yes. Last updated: 2023-10-17.

Condition(s): RSV (respiratory syncytial virus)
Product: Sisunatovir, Denatonium benzoate

Primary endpoint: Palatability Assessment Questionnaire Scoring Metrics: mouth feel, bitterness, sweetness, sourness, saltiness, tongue/mouth burn, overall liking.
Endpoint(s): Assessment of treatment emergent adverse events (TEAEs), clinical laboratory abnormalities and vital signs.

Source: https://euclinicaltrials.eu/ctis-public/view/2023-504924-24-00